EU clinical trial 2024-515705-26-00: Multicentre Randomized trial of Ghrelin in anterior circulation ischemic stroke treated with endovascular thrombectomy. A randomized phase 2 trial.
Sponsor: Rijnstate Ziekenhuis Stichting (Hospital/Clinic/Other health care facility). Phase: Therapeutic exploratory (Phase II). Countries: Netherlands (ongoing, recruiting).
Therapeutic area(s): Diseases [C] - Nervous System Diseases [C10]; Diseases [C] - Cardiovascular Diseases [C14]
Gender: Female, Male. Age: 18-64 years, 65+ years. Enrolment: 80.
Status: Ongoing, recruiting. Start date (EU): 2024-11-11. Decision date: 2024-10-15. Results received: No. Last updated: 2025-12-11.

Condition(s): Stroke
Product: Acyl-ghreline

Primary endpoint: score on the NIHSS at seven days (±1) after stroke onset or at discharge, if earlier
Endpoint(s): the score on the mRS at 90 days (±14) after stroke onset, the score on Barthel index at 90 days (±14) after stroke onset, mortality at 90 days (±14), scores on the NIHSS at 24 (±6) and 72 (±12) hours after stroke onset, score on the telephone version of the Montreal Cognitive Assessment (t-MoCA) at 90 days (±14), infarct size at 72 hours (±24) (based on MRI measurements), blood glucose levels at days 1-7 (or until discharge), blood pressure at days 1-7 (or until discharge), body temperature at days 1-7 (or until discharge), SAEs

Source: https://euclinicaltrials.eu/ctis-public/view/2024-515705-26-00